EU clinical trial 2022-501462-22-00: A Phase 2 Study to Evaluate Efficacy, Safety, and Pharmacokinetics of PBF-999 in the Treatment of Patients with Prader-Willi Syndrome.
Protocol code: PBF-999CT-04
Sponsor: Palo Biofarma S.L. (Pharmaceutical company). Phase: Therapeutic exploratory (Phase II). Countries: Spain (ended).
Therapeutic area(s): Phenomena and Processes [G] - Genetic Phenomena [G05]
Gender: Female, Male. Age: 0-17 years, 18-64 years. Enrolment: 40.
Status: Ended. Start date (EU): 2023-02-22. End date (EU): 2026-02-20. Decision date: 2022-12-01. Results received: No. Last updated: 2025-05-14.

Condition(s): Prader-Willi Syndrome
Product: This is a placebo formulation of PBF-999 capsules. It is registered at eXEVMPD with EV code PRD9864516

Primary endpoint: Treatment-emergent adverse events.
Endpoint(s): Post-treatment HQ-CT questionnaire total score, CGIC questionnaire score., PBF-999 PK parameters: AUC0-3h; Cmax., Physical and biological markers.

Source: https://euclinicaltrials.eu/ctis-public/view/2022-501462-22-00